EU clinical trial 2023-509748-89-00: A Phase 1/2a Dose-Escalating Study to Evaluate the Safety, Tolerability, Pharmacokinetics, and Pharmacodynamics of ARO-DUX4 in Adult Patients With Facioscapulohumeral Muscular Dystrophy Type 1
Protocol code: ARODUX4-1001
Sponsor: Sarepta Therapeutics Inc. (Pharmaceutical company). Phase: Phase I and Phase II (Integrated)- First administration to humans. Countries: Netherlands (ongoing, recruiting), Spain (ongoing, recruiting), Germany (ongoing, recruiting), Italy (ongoing, recruiting).
Therapeutic area(s): Diseases [C] - Nervous System Diseases [C10]
Gender: Female, Male. Age: 18-64 years, 65+ years. Enrolment: 44.
Status: Ongoing, recruiting. Start date (EU): 2025-02-19. Decision date: 2024-08-12. Results received: No. Last updated: 2026-06-19.
Decision dates by country: DE: 2024-08-13, IT: 2024-08-13, ES: 2024-08-12, NL: 2024-08-15

Condition(s): Facioscapulohumeral muscular dystrophy (FSHD)
Product: ARO-DUX4, SODIUM CHLORIDE

Primary endpoint: Incidence, frequency, and severity of treatment-emergent adverse events (TEAEs) in subjects with FSHD1 over time through end of study (EOS) at Day 90 (Part 1) or Day 360 (Part 2)
Endpoint(s): Plasma PK of ARO-DUX4 in subjects with FSHD1, Urinary excretion of ARO-DUX4 in subjects with FSHD1

Source: https://euclinicaltrials.eu/ctis-public/view/2023-509748-89-00